EU clinical trial 2024-514906-30-00: TOLEDDO: Effect of weekly GLP1 agonist treatment in "double diabetes": a randomized, open-label study
Protocol code: TOLEDDO
Sponsor: Centre Hospitalier Universitaire De Dijon (Hospital/Clinic/Other health care facility). Phase: Therapeutic confirmatory (Phase III). Countries: France (ongoing, recruiting).
Therapeutic area(s): Diseases [C] - Nutritional and Metabolic Diseases [C18]
Gender: Female, Male. Age: 18-64 years, 65+ years. Enrolment: 76.
Status: Ongoing, recruiting. Start date (EU): 2024-10-14. Decision date: 2024-07-11. Results received: No. Last updated: 2025-12-09.

Condition(s): "double diabetes"
Product: Ozempic 1 mg solution for injection in pre-filled pen, Ozempic 0.5 mg solution for injection in pre-filled pen, Ozempic 0.25 mg solution for injection in pre-filled pen

Primary endpoint: Percentage of time spent in glycemic target range (0.70-1.80 g/l) between D0 and D180.
Endpoint(s): HbA1c, Weight, waist circumference, Daily dose of insulin administered, Glycemic variability, assessed on data from continuous glucose recording using a continuous glucose meter (Free Style Libre, Guardian or Dexcom) by Standard Deviation (SD) and Mean Amplitude of Glycemic Excursions (MAGE). We will look at the variation in each criterion between the 2 groups between t0 and t6 months, between t0 and 3 months and between t3 months and t6 months., interstitial glucose time < 0.7 g/l and <0.54 g/l (Free Style Libre data), Percentage of adverse events in the 2 groups

Source: https://euclinicaltrials.eu/ctis-public/view/2024-514906-30-00